EU clinical trial 2024-516405-23-00: A Randomized, Open-Label Study of the Efficacy and Safety of Galinpepimut-S (GPS) Maintenance Monotherapy Compared to Investigator's Choice of Best Available Therapy in Subjects with Acute Myeloid Leukemia Who Have Achieved Complete Remission After Second-Line Salvage Therapy
Protocol code: SLSG18-301
Sponsor: Sellas Life Sciences Group Inc. (Pharmaceutical company). Phase: Therapeutic confirmatory (Phase III). Countries: Spain (ended), France (ongoing, recruitment ended), Italy (ended), Germany (ongoing, recruitment ended), Greece (ongoing, recruitment ended).
Therapeutic area(s): Diseases [C] - Neoplasms [C04]
Gender: Female, Male. Age: 18-64 years, 65+ years. Enrolment: 101.
Start date (EU): 2021-06-08. Decision date: 2024-10-31. Results received: No. Last updated: 2025-01-16.
Decision dates by country: IT: 2024-11-18, GR: 2025-01-16, DE: 2024-11-01, ES: 2024-11-04, FR: 2024-10-31

Condition(s): Acute myeloid leukemia (AML) in second or later complete remission (CR2) or second or later complete remission with incomplete platelet recovery (CRp2)
Product: Azacitidine Accord 25 mg/mL powder for suspension for injection, Sargramostim (GM-CSF), Alexan 20 mg/ml oldatos injekció vagy infúzió, Galinpepimut-S, Vidaza 25 mg/ml powder for suspension for injection, Venclyxto 100 mg film-coated tablets, Dacogen 50 mg powder for concentrate for solution for infusion., Azacitidine Accord 25 mg/mL powder for suspension for injection

Primary endpoint: Median overall survival (OS)
Endpoint(s): Leukemia Free Survival (LFS); 6-, 9-, and 12-month OS; 6-, 9-, and 12- month LFS, and presence of MRD.

Source: https://euclinicaltrials.eu/ctis-public/view/2024-516405-23-00